EU clinical trial 2024-520133-72-00: Eltrombopag for the treatment of thrombocytopenia due to low - and intermediate risk myelodysplastic syndromes.
Protocol code: EQoL-MDS
Sponsor: Associazione Qol-One (Patient organisation/association). Phase: Therapeutic exploratory (Phase II). Countries: Italy (ongoing, recruiting).
Therapeutic area(s): Diseases [C] - Hemic and Lymphatic Diseases [C15]
Gender: Female, Male. Age: 18-64 years, 65+ years. Enrolment: 160.
Status: Ongoing, recruiting. Start date (EU): 2025-02-05. Decision date: 2025-02-05. Results received: No. Last updated: 2025-06-24.

Condition(s): Myelodysplastic syndromes
Product: Revolade 25 mg film-coated tablets, Revolade 50 mg film-coated tablets

Primary endpoint: Phase 1. Proportion of patients obtaining CR or R during the six month treatment period., Phase 1. Safety and tolerability parameters including non-hematological laboratory Grade 3/Grade 4 toxicities, change in bone marrow blast counts from baseline and adverse events., Phase 2. Duration of platelet response., Phase 1. Long-term safety and tolerability.
Endpoint(s): Changes in quality of life (QoL) scores., Frequency of platelet transfusions during the treatment and follow-up periods., Duration of platelet transfusion independence., Difference in time to response (time from starting treatment to time of achievement of CR or R)., Duration of response during the treatment and follow-up periods., Incidence and severity of bleeding using the WHO Bleeding Scale., OS and LFS., Eltrombopag population pharmacokinetic parameters and plasma concentration data. The relationship between eltrombopag pharmacokinetics and relevant safety and efficacy endpoints will be explored, as data permit., Phase 1 primary endpoints have been reached and have been publish (Lancet Haematol. 2017 Mar;4(3):e127-e136)

Source: https://euclinicaltrials.eu/ctis-public/view/2024-520133-72-00